EU clinical trial 2023-503799-25-00: Tramadol Administered Orally to Healthy Subjects for the Improvement of its Detection in Biological Matrices in the Context of Anti-Doping Control
Protocol code: IMIMFCTL/TRAM/1
Sponsor: Parc De Salut Mar (Hospital/Clinic/Other health care facility). Phase: Human Pharmacology (Phase I)- Other. Countries: Spain (ended).
Therapeutic area(s): Phenomena and Processes [G] - Metabolism [G03]
Gender: Female, Male. Age: 18-64 years. Enrolment: 25.
Status: Ended. Start date (EU): 2023-04-27. End date (EU): 2023-10-20. Decision date: 2023-04-17. Results received: No. Last updated: 2023-04-17.

Condition(s): healthy subjects

Source: https://euclinicaltrials.eu/ctis-public/view/2023-503799-25-00